EU clinical trial 2023-509349-11-00: A Randomized, Multicenter, Open-Label, Phase 3 Study to Compare the Efficacy and Safety of Acalabrutinib (ACP-196) in Combination with Venetoclax with and without Obinutuzumab Compared to Investigator’s Choice of Chemoimmunotherapy in Subjects with Previously Untreated Chronic Lymphocytic Leukemia Without del(17p) or TP53 Mutation (AMPLIFY)
Protocol code: ACE-CL-311 (AMPLIFY)
Sponsor: Acerta Pharma B.V. (Pharmaceutical company). Phase: Therapeutic confirmatory (Phase III). Countries: Czechia (ongoing, recruitment ended), Slovakia (ongoing, recruitment ended), Hungary (ongoing, recruitment ended), Sweden (ongoing, recruitment ended), Bulgaria (ongoing, recruitment ended), Netherlands (ongoing, recruitment ended), Poland (ongoing, recruitment ended), Denmark (ongoing, recruitment ended), Spain (ongoing, recruitment ended), Austria (ongoing, recruitment ended), France (ongoing, recruitment ended), Italy (ongoing, recruitment ended), Germany (ongoing, recruitment ended).
Therapeutic area(s): Diseases [C] - Neoplasms [C04]
Gender: Female, Male. Age: 18-64 years, 65+ years. Enrolment: 406.
Status: Ongoing, recruitment ended. Start date (EU): 2019-03-22. Decision date: 2024-07-17. Results received: No. Last updated: 2026-06-19.
Decision dates by country: SK: 2024-07-19, CZ: 2024-07-22, DK: 2024-07-21, IT: 2024-07-22, AT: 2024-07-17, FR: 2024-07-22, BG: 2024-08-02, HU: 2024-07-22, PL: 2024-07-18, ES: 2024-07-18, DE: 2024-07-19, NL: 2024-07-22, SE: 2024-07-22

Condition(s): Previously untreated Chronic Lymphocytic Leukemia Without del(17p) or TP53 Mutation
Product: CYCLOPHOSPHAMIDE, VENETOCLAX, ACALABRUTINIB, VENETOCLAX, FLUDARABINE, OBINUTUZUMAB, BENDAMUSTINE, VENETOCLAX, RITUXIMAB

Primary endpoint: Progression-free survival (PFS), defined as the time from randomization to the first occurrence of disease progression or death from any cause (whichever occurs first), as determined by the Independent Review Committee (IRC) according to the International Workshop on Chronic Lymphocytic Leukemia (IWCLL) 2018 criteria.
Endpoint(s): 1: Progression-free survival (PFS), defined as the time from randomization to the first occurrence of disease progression or death from any cause (whichever occurs first), as determined by the investigator assessment., 2: PFS, defined as the time from randomization to the first occurrence of disease progression or death from any cause (whichever occurs first), as determined by the IRC assessment and investigator assessment, 3: Event-free survival (EFS), defined as the time from randomization to the first occurrence of disease progression, initiation of subsequent anti-chronic lymphocytic leukemia (CLL) therapy, or death from any cause per IRC assessment and the investigator assessment, - Overall response rate (ORR), defined as the proportion of subjects with a complete response (CR), complete response with incomplete marrow recovery (CRi), nodular partial response (nPR) or partial response (PR) per IRC assessment and investigator assessment, - Duration of objective response (DOR), defined as the time from the first occurrence of a documented objective response to disease progression or death from any cause per IRC assessment and investigator assessment, - Time to next Therapy (TTNT), defined as the time from randomization to institution of non-protocol specified treatment for CLL, - Minimal residual disease (MRD) negativity rate (determined as the proportion of subjects with MRD-negativity) measured in the peripheral blood by flow cytometry (10-4) at the start of Cycle 9 (in Arm A), the start of Cycle 10 (in Arm B), and 12 weeks after the start of Cycle 6 (in Arm C), - Overall survival (OS), defined as the time from randomization to death from any cause.

Source: https://euclinicaltrials.eu/ctis-public/view/2023-509349-11-00